EU clinical trial 2023-506657-38-00: A Phase 3 Randomized, Double Blind Study of Pembrolizumab Plus Gemcitabine/Cisplatin versus Placebo Plus Gemcitabine/Cisplatin as First-Line Therapy in Participants with Advanced and/or Unresectable Biliary Tract Carcinoma
Protocol code: MK-3475-966
Sponsor: Merck Sharp & Dohme LLC (Pharmaceutical company). Phase: Therapeutic confirmatory (Phase III). Countries: Ireland (ended), Germany (ended), Spain (ended), Netherlands (ended), Italy (ended), France (ended), Belgium (ended).
Therapeutic area(s): Diseases [C] - Neoplasms [C04]
Gender: Female, Male. Age: 18-64 years, 65+ years. Enrolment: 196.
Status: Ended. Start date (EU): 2019-10-02. End date (EU): 2025-03-21. End date: 2025-04-01. Decision date: 2023-11-24. Results received: Yes. Last updated: 2025-04-03.
Decision dates by country: BE: 2024-01-11, IE: 2023-11-24, DE: 2023-11-28, NL: 2023-11-27, FR: 2024-01-10, IT: 2023-11-27, ES: 2023-11-27

Condition(s): Biliary Tract Carcinoma
Product: KEYTRUDA 25 mg/mL concentrate for solution for infusion, Placebo to MK-3475, CISPLATIN, GEMCITABINE

Primary endpoint: Overall Survival (OS)
Endpoint(s): Progression-free Survival (PFS) per Response Evaluation Criteria in Solid Tumors (RECIST) 1.1 as Assessed by Blinded Independent Central Review (BICR), Objective Response Rate (ORR) per RECIST 1.1 as Assessed by BICR, Duration of Response (DOR) per RECIST 1.1 as Assessed by BICR, Number of Participants Who Experienced One or More Adverse Events (AEs), Number of Participants Who Discontinued Study Intervention Due to an Adverse Event (AE)

Source: https://euclinicaltrials.eu/ctis-public/view/2023-506657-38-00